EU clinical trial 2022-502618-95-00: A Phase III Multicenter, Randomized, Double-Blind, Double-Dummy, Parallel-Group Study to Evaluate the Efficacy and Safety of Fenebrutinib Compared with Teriflunomide in Adult Patients with Relapsing Multiple Sclerosis
Protocol code: GN42272
Sponsor: F. Hoffmann-La Roche AG (Pharmaceutical company). Phase: Therapeutic confirmatory (Phase III). Countries: France (ongoing, recruitment ended), Greece (ongoing, recruitment ended), Denmark (ongoing, recruitment ended), Bulgaria (ongoing, recruitment ended), Austria (ongoing, recruitment ended), Poland (ongoing, recruitment ended), Italy (ongoing, recruitment ended).
Therapeutic area(s): Diseases [C] - Nervous System Diseases [C10]
Gender: Female, Male. Age: 18-64 years. Enrolment: 288.
Status: Ongoing, recruitment ended. Start date (EU): 2020-11-24. Decision date: 2024-08-14. Results received: No. Last updated: 2026-07-07.
Decision dates by country: BG: 2024-08-16, GR: 2024-08-20, AT: 2024-08-20, FR: 2024-08-14, IT: 2024-08-20, PL: 2024-08-16, DK: 2024-08-14

Condition(s): Relapsing multiple sclerosis (RMS)
Product: Fenebrutinib, AUBAGIO 14 mg film-coated tablets, Aubagio Placebo, Fenebrutinib Placebo, Fenebrutinib

Primary endpoint: 1.Annualized relapse rate
Endpoint(s): 1. Time to onset of cCDP12, 2. Time to onset of CDP12, 3. Time to onset of cCDP24, 4. Time to onset of CDP24, 5. Total number of gadolinium-enhancing lesions on T1-weighted MRI lesions as detected by MRI, 6. Total number of new and/or enlarging T2-weighted lesions as detected by MRI, 7. Rate of percent change in total brain volume from Week 24 as assessed by MRI, 8. Rate of change from baseline in patient-reported physical impacts of MS, as measured by the Multiple Sclerosis Impact Scale (29-Item), Version 2 (MSIS-29 v2) physical scale, 9. Time to onset of 12-week confirmed 4-point worsening in SDMT score, 10. Change from baseline to Week 48 in the concentration of serum neurofilament light chain (NfL), 11. The nature, frequency, timing, and severity of adverse events; serious adverse events; and adverse events leading to study treatment discontinuation or dose interruptions, 12. Change from baseline in targeted vital signs, 13. Change from baseline in targeted ECG parameters, 14. Change from baseline in clinical laboratory results, 15. Proportion of patients with suicidal ideation or behavior, 16. Plasma concentration of fenebrutinib at specified timepoints

Source: https://euclinicaltrials.eu/ctis-public/view/2022-502618-95-00